EU clinical trial 2023-503715-14-00: A Phase 1/2 Study of the Safety, Tolerability, Pharmacokinetics and Preliminary Efficacy of Relatlimab Plus Nivolumab in Pediatric and Young Adult Participants with Recurrent or Refractory Classical Hodgkin Lymphoma and Non-Hodgkin Lymphoma
Protocol code: CA224-069
Sponsor: Bristol Myers Squibb International Corporation (Pharmaceutical company). Phase: Phase I and Phase II (Integrated)- Other. Countries: Netherlands (ended), Spain (ended), Italy (ended), France (ended).
Therapeutic area(s): Diseases [C] - Neoplasms [C04]
Gender: Female, Male. Age: 0-17 years, 18-64 years. Enrolment: 35.
Status: Ended. Start date (EU): 2022-12-29. End date (EU): 2025-12-03. End date: 2025-12-04. Decision date: 2023-08-17. Results received: Yes. Last updated: 2025-12-16.
Decision dates by country: FR: 2023-09-18, IT: 2023-09-04, NL: 2023-08-17, ES: 2023-08-21

Condition(s): Recurrent or Refractory Classical Hodgkin Lymphoma and Non-Hodgkin Lymphoma
Product: Relatlimab, OPDIVO 10 mg/mL concentrate for solution for infusion.

Primary endpoint: 1/Part A- Dose-limiting toxicities (DLTs), Maximum Tolerated Dose/Recommended Phase 2 Dose; (MTD/RP2D), and incidences of Adverse Events (AEs), Serious Adverse Events (SAEs), AEs leading to discontinuation, deaths and laboratory abnormalities, 2/Part A- maximum observed serum concentration (Cmax), trough observed concentration (Ctrough), time to maximum concentration (Tmax), and area under the curve within a dosing interval (AUC(TAU)) for relatlimab, 3/Part B- Complete Metabolic Response (CMR) rate
Endpoint(s): 1/Part B: Incidences of AEs, SAEs, AEs leading to discontinuation, deaths, and laboratory abnormalities, 2/Part B: Overall Response Rate (ORR)

Source: https://euclinicaltrials.eu/ctis-public/view/2023-503715-14-00